EU clinical trial 2023-506761-65-00: A Two-Part, Seamless, Multi-Center, Randomized, Placebo-Controlled, Double-Blind Study to Investigate the Safety, Tolerability, Pharmacokinetics, Pharmacodynamics and Efficacy of RO7204239 in Combination With Risdiplam (RO7034067) in Patients With Spinal Muscular Atrophy
Protocol code: BN42644
Sponsor: F. Hoffmann-La Roche AG (Pharmaceutical company). Phase: Phase II and Phase III (Integrated). Countries: Portugal (ongoing, recruitment ended), France (ended), Spain (ongoing, recruitment ended), Belgium (ongoing, recruitment ended), Croatia (ongoing, recruitment ended), Netherlands (ongoing, recruitment ended), Germany (ended), Italy (ongoing, recruitment ended), Poland (ongoing, recruitment ended).
Therapeutic area(s): Diseases [C] - Nervous System Diseases [C10]
Gender: Female, Male. Age: 0-17 years, 18-64 years. Enrolment: 114.
Start date (EU): 2022-04-08. Decision date: 2024-08-26. Results received: No. Last updated: 2026-07-13.
Decision dates by country: BE: 2024-08-28, HR: 2024-09-02, IT: 2024-09-30, ES: 2024-08-26, NL: 2024-08-26, DE: 2024-09-09, FR: 2024-09-02, PL: 2024-10-05, PT: 2024-08-28

Condition(s): Spinal Muscular Atrophy (SMA)

Primary endpoint: Part 1 Ambulant Cohorts A-C: 1. Incidence, severity, and causal relationship of adverse events (AEs), with severity determined according to National Cancer Institute Common Terminology Criteria for Adverse Events version 5.0 (NCI CTCAE v5.0), Part 1 Ambulant Cohorts A-C: 2. Change from baseline in vital signs, physical findings, ECG, echocardiogram, relevant echocardiographic parameters, and clinical laboratory results, Part 1 Ambulant Cohorts A-C: 3. Incidence of local and systemic injection reactions, Part 1 Ambulant Cohorts A-C: 4. Incidence of abnormal laboratory findings, Part 1 Ambulant Cohorts A-C: 5. Incidence of abnormal ECG parameters, Part 1 Ambulant Cohorts A-C: 6. Incidence of relevant echocardiographic parameter z scores > 2, Part 1 Ambulant Cohorts A-C: 7. Incidence of abnormal vital signs, Part 1 Ambulant Cohorts A-C: 8. Serum concentration of RO7204239 at specified timepoints, Part 1 Ambulant Cohorts A-C: 9. Maximum observed concentration (Cmax) of RO7204239 at specified timepoints, Part 1 Ambulant Cohorts A-C: 10. Area under the concentration-time curve (AUC) of RO7204239 at specified timepoints, Part 1 Ambulant Cohorts A-C: 11.Trough concentration (Ctrough) of RO7204239 at specified timepoints, Part 1 Ambulant Cohorts A-C: 12. Plasma concentration of risdiplam (and its metabolite M1) at specified timepoints, Part 1 Ambulant Cohorts A-C: 13. Cmax of risdiplam (and its metabolite M1) at specified timepoints, Part 1 Ambulant Cohorts A-C: 14. AUC of risdiplam (and its metabolite M1) at specified timepoints, Part 1 Ambulant Cohorts A-C: 15. Ctrough of risdiplam (and its metabolite M1) at specified timepoints, Part 1 Ambulant Cohorts A-C: 16. Prevalence of anti-drug antibodies (ADAs) against RO7204239 at baseline and incidence of ADAs during the study, Part 1 Ambulant Cohorts A-C: 17. Change from baseline in serum concentrations of total and free latent myostatin, and mature myostatin, Part 1 Ambulant Cohorts A-C: 18. Percentage change from baseline in the contractile area of skeletal muscle in the dominant thigh as assessed by MRI (participants >=5 years) at Week 24 of combination treatment, Part 1 Ambulant Cohorts A-C: 19. Percentage change from baseline in the contractile area of skeletal muscle in the dominant calf as assessed by MRI (participants >=5 years) at Week 24 of combination treatment, Part 1 Ambulant Cohorts A-C: 20. Relationship between PK and PD endpoints, ADA status, safety, or efficacy, Part 2: 21. Change from baseline in the Revised Hammersmith Scale (RHS) total score at Week 72 of combination treatment (Study Week 80)
Endpoint(s): Part 2: 1. Change from baseline in Motor Function Measure (MFM) Domain 1 + Domain 2 (D1 + D2) score at Week 72 of combination treatment (Study Week 80), Part 2: 2. Change from baseline in MFM-32 item total score at Week 72 of combination treatment (Study Week 80), Part 2: 3. Change from baseline in the time taken to rise from floor as measured by RHS Item 25 at Week 72 of combination treatment (Study Week 80), Part 2: 4. Change from baseline in the time taken to walk/run 10 meters as measured by RHS Item 19 at Week 72 of combination treatment (Study Week 80), Part 2: 5. Percent change from baseline in lean mass as assessed by full-body DXA scan (participants >=5 years) at Week 72 of combination treatment (Study Week 80), Part 2: 6. Incidence, severity, and causal relationship of AEs, with severity determined according to NCI CTCAE v5.0, Part 2: 7. Change from baseline in vital signs, physical findings, ECG, echocardiogram, relevant echocardiographic parameters and clinical laboratory results, Part 2: 8. Incidence of local and systemic injection reactions, Part 2: 9. Incidence of abnormal laboratory findings, Part 2: 10. Incidence of abnormal ECG parameters, Part 2: 11. Incidence of relevant echocardiographic parameter z scores >2, Part 2: 12. Incidence of abnormal vital signs, Part 2: 13. Serum concentration of RO7204239 at specified timepoints, Part 2: 14. Cmax of RO7204239 at specified timepoints, Part 2: 15. AUC of RO7204239 at specified timepoints, Part 2: 16. Ctrough of RO7204239 at specified timepoints, Part 2: 17. Plasma concentration of risdiplam (and its metabolite M1) at specified timepoints, Part 2: 18. Cmax of risdiplam (and its metabolite M1) at specified timepoints, Part 2: 19. AUC of risdiplam (and its metabolite M1) at specified timepoints, Part 2: 20. Ctrough of risdiplam (and its metabolite M1) at specified timepoints, Part 2: 21. Prevalence of ADAs at baseline and incidence of ADAs during the study; Impact of ADA on PK, PD, safety and efficacy parameters

Source: https://euclinicaltrials.eu/ctis-public/view/2023-506761-65-00